EU clinical trial 2024-514947-27-00: A Phase 1/2a, Open-label, Dose-finding Study to Evaluate the Safety, Tolerability, Pharmacokinetics and Preliminary Efficacy of BMS-986507 (BL-B01D1) combinations in Adult Participants with Advanced Solid Tumors
Protocol code: CA244-0001
Sponsor: Bristol-Myers Squibb Services Unlimited Company (Pharmaceutical company). Phase: Phase I and Phase II (Integrated)- Other. Countries: Netherlands (ongoing, recruiting), Spain (ongoing, recruiting), France (ongoing, recruiting), Italy (ongoing, recruiting).
Therapeutic area(s): Diseases [C] - Neoplasms [C04]
Gender: Female, Male. Age: 18-64 years, 65+ years. Enrolment: 108.
Status: Ongoing, recruiting. Start date (EU): 2025-06-18. Decision date: 2025-04-08. Results received: No. Last updated: 2026-06-01.
Decision dates by country: ES: 2025-04-08, NL: 2025-04-14, FR: 2025-11-07, IT: 2025-11-12

Condition(s): Advance solid tumors
Product: OSIMERTINIB MESYLATE, OSIMERTINIB MESYLATE, PEMBROLIZUMAB, BL-B01D1

Primary endpoint: Number of participants with adverse events (AEs), Number of participants with serious adverse events (SAEs), Number of participants with AEs meeting protocol defined dose-limiting toxicity (DLT) critera, Number of participants with AEs leading to discontinuation, Number of participants with AEs leading to death, Number of DLTs that occur during the DLT evaluation period
Endpoint(s): Maximum observed serum concentration (Cmax), Time of maximum observed concentration (Tmax), Area under the concentration-time curve from time zero to time of last quantifiable concentration (AUC(0-T)), Area under the serum concentration-time curve within a dosing interval (AUC(TAU)), Objective response rate (ORR), Best Overall Response (BOR)

Source: https://euclinicaltrials.eu/ctis-public/view/2024-514947-27-00